EU clinical trial 2024-511453-22-00: A Study to Investigate the Safety and Efficacy of KQB198 as Monotherapy and in Combination in Participants with Advanced Solid Malignancies
Protocol code: KQB198-101
Sponsor: Kumquat Biosciences Inc. (Laboratory/Research/Testing facility). Phase: Human Pharmacology (Phase I)- First administration to humans. Countries: Italy (ongoing, recruitment ended), France (ongoing, recruitment ended), Spain (ongoing, recruitment ended).
Therapeutic area(s): Diseases [C] - Neoplasms [C04]
Gender: Female, Male. Age: 18-64 years, 65+ years. Enrolment: 112.
Status: Ongoing, recruitment ended. Start date (EU): 2024-10-28. Decision date: 2024-08-29. Results received: No. Last updated: 2026-08-07.
Decision dates by country: ES: 2024-09-06, IT: 2024-09-03, FR: 2024-09-06

Condition(s): Participants with Advanced Solid Malignancies

Source: https://euclinicaltrials.eu/ctis-public/view/2024-511453-22-00